EU clinical trial 2024-514030-20-00: ENGIC - 01 COLOSOTO: A single-arm phase II study evaluating 5-fluorouracil plus Panitumumab (anti-EGFR) and Sotorasib (KRAS G12C inhibitor) in first-line treatment of patients non-eligible for a doublet/triplet chemotherapy with advanced unresectable KRAS G12C mutated colorectal adenocarcinoma
Protocol code: ENGIC 01-COLOSOTO
Sponsor: Fondation Franc.Cancerologie Digestive (Hospital/Clinic/Other health care facility). Phase: Therapeutic exploratory (Phase II). Countries: Italy (ongoing, recruiting), Spain (ongoing, recruiting), Germany (ongoing, recruiting), France (ongoing, recruiting).
Therapeutic area(s): Diseases [C] - Digestive System Diseases [C06]
Gender: Female, Male. Age: 18-64 years, 65+ years. Enrolment: 37.
Status: Ongoing, recruiting. Start date (EU): 2025-08-29. Decision date: 2025-03-24. Results received: No. Last updated: 2026-03-26.
Decision dates by country: IT: 2025-03-26, FR: 2025-03-24, DE: 2025-03-26, ES: 2025-03-27

Condition(s): colorectal cancer
Product: FOLINATE DE CALCIUM HIKMA 10 mg/mL, solution injectable/pour perfusion, Vectibix 20 mg/ml concentrate for solution for infusion, Fluorouracilo Accord 50 mg/ml solución inyectable o para perfusión EFG, Fluorouracil Accord 50 mg/ml Injektions-/ Infusionslösung, Fluorouracile AHCL 50 mg/ml, Soluzione per iniezione o infusione, SOTORASIB, FLUOROURACILE ACCORD 50 mg/ml, solution à diluer pour perfusion, Fluorouracilo Accord 50 mg/ml solución inyectable o para perfusión EFG, FLUOROURACILE ACCORD 50 mg/ml, solution à diluer pour perfusion, Fluorouracile AHCL 50 mg/ml, Soluzione per iniezione o infusione, Fluorouracil Accord 50 mg/ml Injektions-/ Infusionslösung

Primary endpoint: The rate of patients alive without progression 8 months after the inclusion.
Endpoint(s): PFS will be defined as the time between date of inclusion and the date of the first radiological progression using RECIST v1.1 criteria and according to the investigator assessment or death, DCR will be defined at each time-point as complete (CR), partial (PR), stability (S), progression (P) or not evaluable with imageries and according to the investigator, ORR will be evaluated throughout the treatment by the imageries and according to RECIST v1.1 criteria., BOR will be evaluated throughout the treatment by the imageries and according to RECIST v1.1 criteria, DoR is defined as the time between the first response of the patient and the date of radiological progression or death, TTP will be defined as the time between the date of inclusion and the date of the first radiological progression. The death linked to the cancer’s evolution will also be considered as an event, OS is defined by the time between the date of inclusion and the date of death (regardless of the cause), Quality of life will be assessed with the EORTC QLQC30 questionnaire at each evaluation. The questionnaires are completed before the first treatment and during the study, Geriatric assessments will be performed at baseline and during treatment using the G-CODE and G8-SCORE, Toxicity, according to the National Cancer Institute (NCI) Common Terminology Criteria for Adverse Events (CTCAE) v5.0 will be recorded until 30 days after the last administration of treatment

Source: https://euclinicaltrials.eu/ctis-public/view/2024-514030-20-00